EU clinical trial 2023-505893-14-00: A Phase 2b/3 Study of Safety and Efficacy of AMX0035 in Progressive Supranuclear Palsy (ORION)
Protocol code: A35-009
Sponsor: Amylyx Pharmaceuticals Inc. (Pharmaceutical company). Phase: Therapeutic confirmatory (Phase III). Countries: Bulgaria (ended), Austria (ended), Netherlands (ended), Sweden (ended), Belgium (ended), Spain (ended), Poland (ended), France (ended), Germany (ended), Italy (ended).
Therapeutic area(s): Diseases [C] - Nervous System Diseases [C10]
Gender: Female, Male. Age: 18-64 years, 65+ years. Enrolment: 269.
Status: Ended. Start date (EU): 2024-06-04. End date (EU): 2025-08-27. End date: 2025-10-24. Decision date: 2024-03-14. Results received: Yes. Last updated: 2025-06-27.
Decision dates by country: AT: 2024-03-25, BE: 2024-03-20, BG: 2024-03-20, SE: 2024-03-18, NL: 2024-03-14, PL: 2024-03-25, FR: 2024-03-18, DE: 2024-03-14, IT: 2024-03-21, ES: 2024-03-18

Condition(s): Progressive Supranuclear Palsy
Product: Placebo matching AMX0035, AMX0035

Primary endpoint: Change from Baseline at Week 52 in the total PSPRS Score * *A primary endpoint—which meets evidentiary requirements of the United States of America (USA) and outside of the USA, respectively—was selected as follows: change from baseline in the 10-item PSPRS at Week 52 (for the USA) and change from baseline in the 28-item PSPRS at Week 52 (for outside of the USA). For each region, only the endpoint which meets evidentiary requirements of that region is considered the primary endpoint; ...
Endpoint(s): Change from Baseline at Week 52 in the PSPRS Score * * Same as above, Change from Baseline at Week 52 in the MDS-UPDRS Part II Score., Frequency of treatment-emergent adverse events (TEAEs) and serious adverse events (SAEs)

Source: https://euclinicaltrials.eu/ctis-public/view/2023-505893-14-00